EU clinical trial 2023-507678-42-00: J2G-OX-Y001 - A Multi-Center Expanded Access Program (EAP) for the Treatment of Patients with Locally Advanced or Metastatic Solid Tumors with Rearranged During Transfection (RET) Activation (LIBRETTO-201)
Protocol code: LOXO-RET-18037
Sponsor: Eli Lilly & Co. (Pharmaceutical company). Phase: Therapeutic use (Phase IV). Countries: Italy (ended), France (ongoing, recruitment ended), Poland (ongoing, recruitment ended), Spain (ended).
Therapeutic area(s): Diseases [C] - Neoplasms [C04]
Gender: Female, Male. Age: 18-64 years, 65+ years. Enrolment: 224.
Start date (EU): 2019-10-24. Decision date: 2024-07-16. Results received: No. Last updated: 2026-08-06.
Decision dates by country: PL: 2024-07-18, IT: 2024-07-22, ES: 2024-07-16, FR: 2024-07-18

Condition(s): Non Small Cell Lung Cancer; Medullary Thyroid Cancer; Colon Cancer; Breast Cancer; Pancreatic Cancer; Papillary Thyroid Cancer; Other Solid Tumors With Evidence of Activating RET Alteration;
Product: SELPERCATINIB, SELPERCATINIB

Primary endpoint: There are no endpoints or data analysis for this EAP trial.
Endpoint(s): There are no endpoints or data analysis for this EAP trial.

Source: https://euclinicaltrials.eu/ctis-public/view/2023-507678-42-00